EU clinical trial 2024-513373-43-00: A 104-WEEK, MULTICENTER, SINGLE-ARM, LONG-TERM, PHASE 3 EXTENSION TRIAL INVESTIGATING THE SAFETY AND EFFICACY OF GLEPAGLUTIDE IN ADULT PATIENTS WITH SHORT BOWEL SYNDROME (SBS) COMPLETING THE EASE SBS 2 TRIAL
Protocol code: ZP1848-20110
Sponsor: Zealand Pharma A/S (Pharmaceutical company). Phase: Therapeutic confirmatory (Phase III). Countries: Denmark (ended), Belgium (ended), Germany (ended), France (ended), Netherlands (ended), Poland (ended).
Therapeutic area(s): Diseases [C] - Digestive System Diseases [C06]
Gender: Female, Male. Age: 18-64 years, 65+ years. Enrolment: 49.
Status: Ended. Start date (EU): 2021-06-11. End date (EU): 2026-02-11. End date: 2026-03-23. Decision date: 2024-09-10. Results received: No. Last updated: 2025-11-03.
Decision dates by country: DK: 2024-09-11, NL: 2024-09-10, DE: 2024-09-18, BE: 2024-09-13, PL: 2024-09-30, FR: 2024-09-16

Condition(s): Short bowel syndrome
Product: Glepaglutide 20.0 mg/mL

Primary endpoint: Incidence and type of AEs, with onset or worsening following Visit 1
Endpoint(s): Incidence and type of serious adverse events (SAEs) and AEs of special interest (AESIs) (with onset or worsening following Visit 1), Changes from baseline in: - Vital signs - Electrocardiogram, Changes from baseline in: - Hematology - Biochemistry - Urinalysis, Immunogenicity (anti-glepaglutide antibodies, antibody reactivity to ZP18481-34, -cross reactivity to glucagon-like peptide-2 (GLP-2), glepaglutide neutralizing antibodies), The secondary efficacy endpoints are: Reduction in weekly PS volume (prescribed) from baseline, The secondary efficacy endpoints are: Reduction of at least 20% in weekly PS volume (prescribed) from baseline, The secondary efficacy endpoints are: Reduction in days on PS ≥ 1 day/week from baseline, The secondary efficacy endpoints are: Reduction in weekly PS volume of 100% (weaned off)

Source: https://euclinicaltrials.eu/ctis-public/view/2024-513373-43-00